EU clinical trial 2023-505126-34-00: SOLOAGO - Luteal phase support by GnRH agonist alone after GnRH agonist triggering compared to the reference protocol (hCG triggering and luteal support with progesterone) in IVF: a randomized controlled trial.
Protocol code: APHP220667
Sponsor: Assistance Publique Hopitaux De Paris (Hospital/Clinic/Other health care facility). Phase: Therapeutic confirmatory (Phase III). Countries: France (ongoing, recruitment ended).
Therapeutic area(s): Phenomena and Processes [G] - Biological Phenomena [G16]
Gender: Female. Age: 18-64 years. Enrolment: 652.
Status: Ongoing, recruitment ended. Start date (EU): 2024-06-27. Decision date: 2023-10-17. Results received: No. Last updated: 2026-02-25.

Condition(s): IVF (In vitro fertilization) or ICSI (intracytoplasmic sperm injection) protocol with embryo transfer planned on the same cycle.
Product: DECAPEPTYL 0,1 mg, poudre et solvant pour solution injectable (S.C.), CHORIOGONADOTROPIN ALFA, SYNAREL 0,2 mg/dose, solution pour pulvérisation nasale, PROGESTERONE

Primary endpoint: Live birth, defined as the presence of a live birth after 22 weeks. Twin pregnancies will be counted as one birth.
Endpoint(s): 1. Embryo implantation defined by the presence of a gestational sac visible on the first ultrasound (5-8 weeks), 2. Early pregnancy defined by the presence of an hCG level > 10 IU/ml 14 days after oocyte retrieval., 3. Clinical pregnancy, defined by the presence of an intrauterine gestational sac with embryo showing cardiac activity on ultrasound for 5-10 SA, 4. Miscarriage before 12 weeks, defined by the cessation of development of an early pregnancy before 12 weeks. An early pregnancy is defined as having an hCG level > 10 IU/ml 14 days after oocyte retrieval., 5. Ongoing pregnancy, defined as the presence of an intrauterine sac with an embryo with cardiac activity visible on ultrasound between 11 WA and 13 WA + 6 days (first trimester ultrasound of pregnancy)., 6. Pregnancy hypertension and its term of onset, pre-eclampsia and its term of onset, gestational diabetes and its term of onset, term and mode of delivery, medical termination of pregnancy, late miscarriage (between 12 and 22 SA), fetal death in utero, 7. Ovarian hyperstimulation syndrome defined as the presence of a moderate to severe syndrome, early and late. Early defined as the period before D10 post puncture and late defined as OHSS linked to pregnancy, according to the ABM reference system., 8. Level of progesterone, estradiol, LH and hCG on the day of the puncture and on D7 post puncture, 9. Progesterone, estradiol, LH and hCG levels during follow-up, presence of pregnancy and presence of miscarriage, 10. All adverse events up to delivery, Number of oocytes collected, number of mature oocytes, number of fertilized oocytes, number of embryos on the second day of development, number of blastocysts obtained, number of blastocysts transferred, number of blastocysts frozen

Source: https://euclinicaltrials.eu/ctis-public/view/2023-505126-34-00